EU clinical trial 2024-517632-22-00: A Phase 3, Double-Blind, Randomized, Vehicle-Controlled, Efficacy and Safety Study of Ruxolitinib Cream in Participants With Hidradenitis Suppurativa: Topical Ruxolitinib Evaluation in Hidradenitis Suppurativa (TRuE-HS1)
Protocol code: INCB018424-324
Sponsor: Incyte Corp. (Pharmaceutical company). Phase: Therapeutic confirmatory (Phase III). Countries: Poland (ongoing, recruitment ended), Italy (ongoing, recruitment ended), Spain (ongoing, recruitment ended), Germany (ongoing, recruitment ended), France (ongoing, recruitment ended), Bulgaria (ongoing, recruitment ended).
Therapeutic area(s): Diseases [C] - Skin and Connective Tissue Diseases [C17]
Gender: Female, Male. Age: 0-17 years, 18-64 years, 65+ years. Enrolment: 116.
Status: Ongoing, recruitment ended. Start date (EU): 2025-10-06. Decision date: 2025-08-05. Results received: No. Last updated: 2026-03-27.
Decision dates by country: FR: 2025-08-08, PL: 2025-08-11, DE: 2025-08-05, ES: 2025-08-08, IT: 2025-08-05, BG: 2025-08-11

Condition(s): Hidradenitis Suppurativa
Product: Ruxolitinib (INCB018424) cream, Vehicle cream (same formulation of cream as the test product but without active substance and the phosphoric acid)

Primary endpoint: The binary response status of HiSCR75 (defined as a ≥ 75% reduction from baseline in total AN count with no increase from baseline in abscess or draining tunnel count) at Week 16.
Endpoint(s): Additional endpoints for EU–Treatment-IR Population: HiSCR75 at Week 16. The binary response status of ≥ 1 HS flare during the DBVC period. The binary response status of participants with a baseline Skin Pain NRS score ≥ 3 who achieve Skin Pain NRS3 at Week 16. More endpoints in protocol.

Source: https://euclinicaltrials.eu/ctis-public/view/2024-517632-22-00